EU clinical trial 2023-505341-23-00: A Phase III Randomized, Open-Label, Multi-Center, GlobalStudy of Durvalumab and Bacillus Calmette-Guerin (BCG)Administered as Combination Therapy Versus BCG Alone inHigh-Risk, BCG Naïve Non Muscle Invasive Bladder Cancer Patients (POTOMAC)
Protocol code: D419JC00001(POTOMAC)
Sponsor: AstraZeneca AB (Pharmaceutical company). Phase: Therapeutic confirmatory (Phase III). Countries: Germany (ongoing, recruitment ended), Austria (ongoing, recruitment ended), France (ongoing, recruitment ended), Belgium (ongoing, recruitment ended), Netherlands (ongoing, recruitment ended), Poland (ongoing, recruitment ended), Spain (ongoing, recruitment ended).
Therapeutic area(s): Diseases [C] - Neoplasms [C04]
Gender: Female, Male. Age: 18-64 years, 65+ years. Enrolment: 466.
Status: Ongoing, recruitment ended. Start date (EU): 2018-07-27. Decision date: 2024-03-12. Results received: No. Last updated: 2026-07-22.
Decision dates by country: PL: 2024-03-25, AT: 2024-03-18, BE: 2024-03-19, DE: 2024-03-15, FR: 2024-03-12, NL: 2024-03-13, ES: 2024-03-12

Condition(s): Non-muscle invasive bladder cancer
Product: INFLIXIMAB, OncoTICE® powder for instillation fluid for intravesical use containing 2-8 x 108 CFU Tice BCG., DURVALUMAB, IMFINZI 50 mg/mL concentrate for solution for infusion., Placebo, MYCOPHENOLATE MOFETIL

Primary endpoint: Disease-free survival (DFS)
Endpoint(s): Disease free at 24 months (DFS24) Survival at 5 years (OS5) Complete response rate (CRR) Any disease-free survival (aDFS) Time to muscle-invasive bladder (MIBC) cancer ormetastasis Time to cystectomy. Time to development of upper track urothelial carcinoma(UTUC) Disease related symptoms Patient reported treatment tolerability Assessment of PK of Durvalumab Immunogenicity of Durvalumab (ADA) in combination with BCG

Source: https://euclinicaltrials.eu/ctis-public/view/2023-505341-23-00